EU clinical trial 2024-516801-22-00: SWOG S1007: A Phase III, Randomized Clinical Trial of Standard Adjuvant Endrocrine Therapy +/- Chemotheraphy in Patients with 1-3 Positive Nodes Hormone Receptor-Positive and HER2-Negative Breast Cancer with Recurrence Score (RS) of 25 or less
Protocol code: CTRIAL-IE 12-01
Sponsor: Cancer Trials Ireland (Patient organisation/association). Phase: Therapeutic confirmatory (Phase III). Countries: Ireland (ongoing, recruitment ended).
Therapeutic area(s): Diseases [C] - Neoplasms [C04]
Gender: Female. Age: 18-64 years, 65+ years. Enrolment: 141.
Status: Ongoing, recruitment ended. Start date (EU): 2012-04-26. Decision date: 2024-08-26. Results received: No. Last updated: 2026-06-22.

Condition(s): Patients with 1-3 positive Nodes, Hormone Receptor-Positive and Her2-Negative Breast Cancer with recurrence Score (RS) of 25 or Less
Product: Epirubicin 2 mg/ml Solution for Injection, TAXOTERE 20 mg/0.5 ml concentrate and solvent for solution for infusion, Tamoxifen 20 mg Tablets, Doxorubicin Teva 2 mg/ml Concentrate for Solution for Infusion, Endoxana Injection 500 mg Powder for Solution for Injection, Paclitaxel 6mg/ml Concentrate for Solution for Infusion, Fluorouracil 50 mg/ml Solution for Injection or Infusion, Anastrozole 1 mg film-coated tablets

Primary endpoint: DFS: Invasive disease-free survival (DFS) - time from the second registration (randomization) to local, regional, or distant recurrence, new invasive primary, or death due to any cause. The STEEP definition of invasive disease-free survival (IDFS) is used, although it is referred to here by the more common acronym DFS. Survival times are censored at time of last follow-up for individuals who did not have any event meeting the above definition.
Endpoint(s): OS: Overall survival (OS) - time from the second registration (randomization) to death due to any cause. Survival times are censored at time of last follow-up for individuals who are not known to have died., DDFS: Distant disease-free survival (DDFS) - time from second registration to distant recurrence, new invasive primary, or death due to any cause. Patients who have local or regional recurrence are continued to be followed for a distant event or death. Survival times are censored at time of last follow-up for individuals who are not known to have died and have not had a distant recurrence or new primary., LDFI: Local-regional disease-free interval (LDFI) - time from second registration to local/regional recurrence. 3 Patients who have distant recurrence or a new primary or who die without recurrence are censored at time of this event. The analysis of this endpoint must account for informative censoring using a competing risk framework. Survival times are also censored at time of last follow-up for individuals who are not known to have died and have had a recurrence or new primary., Toxicity: Toxicities using standard NCI-CTCAE criteria (CTCAE Version 4.0).

Source: https://euclinicaltrials.eu/ctis-public/view/2024-516801-22-00